EU clinical trial 2024-519991-18-00: Evaluation of 200 mg of Rituximab every 6 months as maintenance treatment of Rituximab-treated patients with rheumatoid arthritis: a non-inferiority prospective randomised controlled trial (RADAR)
Protocol code: 9424
Sponsor: Les Hopitaux Universitaires De Strasbourg (Hospital/Clinic/Other health care facility). Phase: Therapeutic use (Phase IV). Countries: France (ongoing, recruiting).
Therapeutic area(s): Diseases [C] - Immune System Diseases [C20]
Gender: Female, Male. Age: 18-64 years, 65+ years. Enrolment: 249.
Status: Ongoing, recruiting. Start date (EU): 2025-06-16. Decision date: 2025-04-11. Results received: No. Last updated: 2026-03-24.

Condition(s): Rheumatoid Arthritis
Product: SODIUM CHLORIDE, RITUXIMAB, RITUXIMAB

Primary endpoint: Mean reduction of rheumatoid arthritis activity score (DAS28-CRP) between day 0 and 12 months to show non-inferiority of the lower dose.
Endpoint(s): DAS28-CRP at day 0, 6 months and 12 months, DAS28 categories : Remission: DAS28 < 2.6 ; Low Disease Activity: 2.6 ≤ DAS28 ≤ 3.2 ; Moderate Activity: 3.2 < DAS28 ≤ 5.1; High Disease Activity: DAS28 > 5.1 ; Boolean Remission Criteria defined as tender joint count (TJC) ≤ 1, swollen joint count (SJC) ≤ 1, CRP (mg/dL) ≤ 1, Patient global assessment (on a 0–10 scale) ≤ 1 at day 0, 6 months and 12 months, Number of Rituximab infusions, number of patients switching or initiating a cDMARD or switching from Rituximab to another bDMARD, number of patients using oral corticosteroids at a dose greater than 10 mg/day throughout study period, Number of flares throughout study period, FLARE questionnaire at 6 and 12 months, RAPID-3 score and RAID at day 0, 6 months and 12 months, EQ5D-5L and SF-36 at day 0, 6 months and 12 months, B, T and NK cell phenotyping at day 0, 6 months and 12 months, IgG, IgA and IgM at day 0, 6 months and 12 months, Vaccinal serologies at day 0, 6 months and 12 months (Diphteria, pneumococcus, tetanus and Haemophilus influenzae type B), HACA at day 0 and 12 months, Evolution of Torque Teno Virus (TTV) viral load in the serum of patients between day 0 and 12 months, Number of infections and serious infections, Number of adverse events and serious adverse events

Source: https://euclinicaltrials.eu/ctis-public/view/2024-519991-18-00